EU clinical trial 2025-522805-39-00: A Phase II, Randomized, Open-Label Study Evaluating Two Inavolisib Dose Levels in Combination with Fulvestrant in Participants with PIK3CA-Mutated, HR-Positive, HER2-Negative Locally Advanced or Metastatic Breast Cancer
Protocol code: WO46063
Sponsor: F. Hoffmann-La Roche AG (Pharmaceutical company). Phase: Therapeutic exploratory (Phase II). Countries: Belgium (ongoing, recruiting), Spain (ongoing, recruiting).
Therapeutic area(s): Diseases [C] - Neoplasms [C04]
Gender: Female, Male. Age: 18-64 years, 65+ years. Enrolment: 20.
Status: Ongoing, recruiting. Start date (EU): 2026-02-06. Decision date: 2026-01-23. Results received: No. Last updated: 2026-07-01.
Decision dates by country: BE: 2026-01-23, ES: 2026-01-23

Condition(s): Phosphatidylinositol-4,5-bisphosphate 3-kinase catalytic subunit alpha gene (PIK3CA)-Mutated, hormone receptor-positive (HR-Positive), human epidermal growth factor receptor 2 (HER2)-Negative Locally Advanced or Metastatic Breast Cancer
Product: INAVOLISIB, INAVOLISIB, FULVESTRANT

Primary endpoint: Confirmed Objective Response Rate (ORR), defined as the proportion of participants with a complete response or partial response on at least two consecutive occasions ≥ 4 weeks apart, as determined by the investigator according to RECIST v1.1, Incidence of key inavolisib-associated adverse events, including hyperglycemia, stomatitis/oral mucositis, and diarrhea., Severity of key PI3K-inhibition associated adverse events, including hyperglycemia, stomatitis/oral mucositis, and diarrhea as per Common Terminology Criteria for Adverse Events (CTCAE) v5.0.
Endpoint(s): DOR, duration of response, defined as the time from the first occurrence of a confirmed objective response to the first occurrence of disease progression or death from any cause (whichever occurs first), as determined by the investigator according to RECIST v1.1, TTR, time to response, defined as the time from randomization to first occurrence of a documented objective response as determined by the investigator according to RECIST v1.1, PFS, progression-free survival, defined as the time from randomization to the first occurrence of disease progression, as determined by the investigator according to RECIST v1.1, or death from any cause (whichever occurs first), Incidence of treatment discontinuations due to adverse events, Change from baseline in targeted clinical laboratory test results, Presence, frequency of occurrence, severity, and/or degree of interference with daily activities of symptomatic treatment toxicities (i.e., diarrhea, nausea, vomiting, decreased appetite, fatigue, mouth sores, and rash), as assessed through use of the National Cancer Institute Patient-Reported outcomes Common Terminology Criteria for Adverse Events (NCI PRO-CTCAE) instrument, Presence and frequency of occurrence of selected hyperglycemia symptoms (i.e. increased thirst and frequent urination), as assessed through the European Organisation for Research and Treatment of Cancer (EORTC) IL382, Proportion of participants reporting each response option at each assessment timepoint by treatment arm for treatment side effect bother single-item General Population Question 5 (GP5) from the Functional Assessment of Cancer Therapy-General questionnaire (FACT-G), Change from baseline/worsening in symptomatic treatment toxicities and treatment side effect bother as assessed through use of the PRO-CTCAE, EORTC IL382, and FACT-G GP5 item, respectively

Source: https://euclinicaltrials.eu/ctis-public/view/2025-522805-39-00